EU clinical trial 2024-512934-14-00: Ramucirumab plus Irinotecan / Leucovorin / 5-FU versus Ramucirumab plus Paclitaxel in patients with advanced or metastatic adenocarcinoma of the stomach or gastroesophageal junction, who failed one prior line of palliative chemotherapy - The Phase II/III RAMIRIS STUDY
Protocol code: RAMIRIS
Sponsor: Frankfurter Institut Fuer Klinische Krebsforschung IKF GmbH (Pharmaceutical company). Phase: Therapeutic confirmatory (Phase III). Countries: Italy (ended), Austria (ended), Germany (ended).
Therapeutic area(s): Diseases [C] - Digestive System Diseases [C06]
Gender: Female, Male. Age: 18-64 years, 65+ years. Enrolment: 319.
Status: Ended. Start date (EU): 2016-11-07. End date (EU): 2026-05-04. Decision date: 2024-11-04. Results received: No. Last updated: 2025-06-23.
Decision dates by country: AT: 2024-11-08, DE: 2024-11-04, IT: 2024-12-09

Condition(s): advanced or metastatic adenocarcinoma of the stomach or gastroesophageal junctions, who failed prior line of palliative chemotherpay
Product: Irinotecan Kabi 20 mg/ml Konzentrat zur Herstellung einer Infusionslösung, 5-FU medac 50 mg/ml, Injektionslösung, Calciumfolinat Sandoz 10 mg/ml – Injektions-/Infusionslösung, SANIFOLIN polvere per soluzione iniettabile, Irinotecan Kabi 20 mg/ml Konzentrat zur Herstellung einer Infusionslösung, Paclitaxel Aurobindo 6 mg/ml concentrato per soluzione per infusione, Paclitaxel Accord 6 mg/ml Konzentrat zur Herstellung einer Infusionslösung, Leucovorin 10 mg/ml Lösung zur Injektion/ Infusion, Cyramza 10 mg/ml concentrate for solution for infusion, Paclitaxel Ribosepharm 6 mg/ml Konzentrat zur Herstellung einer Infusionslösung, Cyramza 10 mg/ml concentrate for solution for infusion, Irinotecan Aurobindo 20 mg/ml concentrato per soluzione per infusione, Fluorouracil Accord 50 mg/ml Injektions- oder Infusionslösung, Fluorouracile Teva 1 g/20 ml soluzione per infusione

Primary endpoint: Co-primary endpoints: Overall Survival (OS) defined as the time from randomization to death from any cause and assessed according to Kaplan-Meier and Objective Overall Response Rate (ORR) defined as the proportion of patients with complete or partial remission according to RECIST 1.1
Endpoint(s): To compare treatment arms with respect to • Progression-free survival • Objective response rate (CR + PR) • Tumor control rate (CR, PR, SD) • Safety (according to NCI-CTCAE V 4.03) and tolerability • Assessment of quality of life during treatment and follow-up.

Source: https://euclinicaltrials.eu/ctis-public/view/2024-512934-14-00